EU clinical trial 2022-500631-36-00: High Dose Steroids in Children with Stroke and Unilateral Focal Arteriopathy: A Multicentre Randomized Controlled Trial
Protocol code: PASTA-1473
Sponsor: Insel Gruppe AG (Hospital/Clinic/Other health care facility). Phase: Therapeutic confirmatory (Phase III). Countries: France (ongoing, recruiting), Austria (ongoing, recruiting), Germany (ongoing, recruiting), Denmark (authorised, recruitment pending), Sweden (authorised, recruitment pending).
Therapeutic area(s): Diseases [C] - Cardiovascular Diseases [C14]
Gender: Female, Male. Age: 0-17 years. Enrolment: 35.
Start date (EU): 2024-07-10. Decision date: 2024-07-05. Results received: No. Last updated: 2026-06-18.
Decision dates by country: DE: 2024-07-09, FR: 2024-07-05, SE: 2025-05-26, DK: 2025-06-03, AT: 2024-07-09

Condition(s): Focal cerebral arteriopathy and childhood stroke Focal cerebral arteriopathy (FCA) is an inflammatory vessel wall disease provoked by infection.
Product: Methylprednisolut 1000 mg, SOLUMEDROL 500 mg, poudre pour solution injectable, PREDNISOLONE, Aprednislon 1 mg Tabletten, SOLUMEDROL 500 mg, poudre pour solution injectable, Prednisolon 1 mg JENAPHARM, Methylprednisolut 16 mg, METHYLPREDNISOLONE, SOLUPRED 5 mg, comprimé effervescent, Methylprednisolut 32 mg, Solu-Medrol® 500 mg – Trockenstechampulle mit Lösungsmittel, Prednisolon 20 mg JENAPHARM, Solu-Medrol® 1000 mg – Trockenstechampulle mit Lösungsmittel, Prednisolon 10 mg JENAPHARM, Methylprednisolut 250 mg, Prednisolon 5 mg JENAPHARM, Prednisolon 50 mg JENAPHARM, Aprednislon 25 mg Tabletten, Aprednislon 5 mg Tabletten

Primary endpoint: The primary outcome is change in FCA Severity Score (FCASS) from baseline to 1 month
Endpoint(s): Neurological deficits over time as determined by PSOM, RRQ, modified Rankin scale (mRS) and Vineland Adaptive Behaviour Scale (VABS) at 6 and 12 months, Neurocognitive outcome at 12 months, Recurrence-free survival, Change in FCASS at (3) and 6 months, Residual vasculopathy at 6 months

Source: https://euclinicaltrials.eu/ctis-public/view/2022-500631-36-00